EU clinical trial 2024-513881-20-00: First-line treatment with osimertinib in EGFR-mutated non-small cell lung cancer, coupled to extensive translational studies (The FIOL-study)
Protocol code: ESR-18-13686
Sponsor: Vestre Viken HF (Hospital/Clinic/Other health care facility). Phase: Therapeutic exploratory (Phase II). Countries: Norway (ended), Lithuania (ended), Sweden (ended).
Therapeutic area(s): Diseases [C] - Neoplasms [C04]; Diseases [C] - Respiratory Tract Diseases [C08]
Gender: Female, Male. Age: 18-64 years, 65+ years. Enrolment: 96.
Status: Ended. Start date (EU): 2018-11-19. End date (EU): 2025-10-31. Decision date: 2024-11-14. Results received: No. Last updated: 2024-11-28.
Decision dates by country: LT: 2024-11-28, SE: 2024-11-14, NO: 2024-11-14

Condition(s): EGFR-mutated non-small cell lung cancer
Product: TAGRISSO 40 mg film-coated tablets, TAGRISSO 80 mg film-coated tablets

Primary endpoint: To assess the efficacy of osimertinib by assessment of objective response rate (ORR).
Endpoint(s): To further assess the efficacy of osimertinib in terms of Progression free survival (PFS), To further assess the efficacy of osimertinib in terms of Duration of Response (DoR), To further assess the efficacy of osimertinib in terms of Disease Control Rate (DCR), To further assess the efficacy of osimertinib in terms of Intracranial ORR, To further assess the efficacy of osimertinib in terms of intracranial DoR, To further assess the efficacy of osimertinib in terms of intracranial progression free survival (iPFS), To further assess the efficacy of osimertinib in terms of tumour shrinkage, To further assess the efficacy of osimertinib in terms of overall survival (OS), To confirm the safety profile of osimertinib, Exploratory objectives Molecular characterization of blood and tissue before commencement on osimertinib, and at progression on osimertinib, Exploratory objectives: NGS (deep sequencing) of tumour tissue, Exploratory objectives: Array-based microRNA, methylation, mRNA expression, Exploratory objectives : Immunohistochemistry (IHC) on AXL, cMET, CD73 etc, Exploratory objectives: Exploratory analyses to be determined, Mutational analyses (ctDNA) and conventional tumour markers during therapy

Source: https://euclinicaltrials.eu/ctis-public/view/2024-513881-20-00